EU clinical trial 2025-524082-25-00: A Phase 1b/2a, Multicenter, Open-Label Study to Evaluate the Safety, Tolerability, Pharmacokinetics, and Pharmacodynamics of DNL952 in Adult Participants with Late-Onset Pompe Disease
Protocol code: DNLI-J-0001
Sponsor: Denali Therapeutics Inc. (Pharmaceutical company). Phase: Phase I and Phase II (Integrated)- First administration to humans. Countries: Germany (authorised, recruitment pending), Netherlands (authorised, recruitment pending).
Therapeutic area(s): Diseases [C] - Musculoskeletal Diseases [C05]
Gender: Female, Male. Age: 18-64 years, 65+ years. Enrolment: 6.
Status: Authorised, recruitment pending. Decision date: 2026-06-01. Results received: No. Last updated: 2026-06-18.
Decision dates by country: DE: 2026-06-03, NL: 2026-06-01

Condition(s): Late-Onset Pompe Disease
Product: DNL952

Primary endpoint: Incidence, severity, and seriousness of TEAEs ; Incidence and severity of IRRs
Endpoint(s): DNL952 serum PK parameters (when feasible): – Cmax – tmax – AUClast – AUC∞ (single dose only) – AUCt (multiple doses only) – t1/2, Incidence of ADAs during the study

Source: https://euclinicaltrials.eu/ctis-public/view/2025-524082-25-00